EU clinical trial 2025-521512-20-00: EFFECTS OF SAFINAMIDE VERSUS PLACEBO ON PAIN IN PATIENTS WITH PARKINSON’S DISEASE WITH MOTOR FLUCTUATIONS: A RANDOMIZED, CONTROLLED, DOUBLE-BLIND CLINICAL TRIAL. Protocol code: SAVE PAIN 2025
Protocol code: SAVE PAIN 2025
Sponsor: Azienda Ospedaliera Universitaria Integrata Verona (Hospital/Clinic/Other health care facility). Phase: Therapeutic confirmatory (Phase III). Countries: Italy (authorised, recruitment pending).
Therapeutic area(s): Diseases [C] - Nervous System Diseases [C10]
Gender: Female, Male. Age: 18-64 years, 65+ years. Enrolment: 60.
Status: Authorised, recruitment pending. Decision date: 2025-08-05. Results received: No. Last updated: 2025-10-16.

Condition(s): PARKINSON’S DISEASE WITH MOTOR FLUCTUATIONS
Product: Safinamide 100 mg PLACEBO: Safinamide 100 mg PLACEBO film-coated tablets have the same composition as the relevant Investigational Medicinal Products except for the presence of Active Substance that is missing in the placebo formulations. The missing amount of active substance Safinamide methanesulfonate is replaced in the PLACEBO formulation with the same amount of Microcrystalline cellulose, one of the excipients already present in the authorised formulation, Xadago 100 mg film-coated tablets, Xadago 50 mg film-coated tablets, Safinamide 50 mg PLACEBO: Safinamide 50 mg, PLACEBO film-coated tablets have the same composition as the relevant Investigational Medicinal Products except for the presence of Active Substance that is missing in the placebo formulations. The missing amount of active substance Safinamide methanesulfonate is replaced in the PLACEBO formulation with the same amount of Microcrystalline cellulose, one of the excipients already present in the authorised formulation.

Primary endpoint: We could hypothesize a mean change of NRS difference between the experimental (safinamide) and the control group (placebo) of 1.6 points on NRS in favor of the experimental group after 12 weeks of treatment
Endpoint(s): We hypothesize that the safinamide group will demonstrate a greater mean improvement compared to the placebo group across several secondary outcome measures. The expected between-group difference for UPDRS Part III and PDQ-39 is estimated to range from –0.9 to –2.3 points and –16.5 to – 18.6 points, respectively. For KPPS, BPI (intensity and interference), and UPDRS Part IV it is not possible to estimate a between-group difference.

Source: https://euclinicaltrials.eu/ctis-public/view/2025-521512-20-00